EU clinical trial 2023-503484-42-00: A Phase 1/2 Study of BMS-986449 Alone and in Combination with Nivolumab in Participants with Advanced Solid Tumors
Protocol code: CA120-1001
Sponsor: Bristol-Myers Squibb Services Unlimited Company (Pharmaceutical company). Phase: Phase I and Phase II (Integrated)- First administration to humans. Countries: Spain (ended), Italy (ended), Netherlands (ongoing, recruitment ended), France (ongoing, recruitment ended), Belgium (ended).
Therapeutic area(s): Diseases [C] - Nutritional and Metabolic Diseases [C18]
Gender: Female, Male. Age: 18-64 years, 65+ years. Enrolment: 75.
Start date (EU): 2023-10-19. Decision date: 2023-10-05. Results received: No. Last updated: 2025-11-06.
Decision dates by country: IT: 2023-10-05, ES: 2023-10-05, FR: 2023-10-09, NL: 2023-10-05, BE: 2023-10-09

Condition(s): Advanced, metastatic, solid malignancy
Product: HELIOS Degrader, OPDIVO 10 mg/mL concentrate for solution for infusion.

Primary endpoint: Incidence of dose-limiting toxicities, adverse events (AEs), serious AEs (SAEs, adverse events leading to discontinuation, and deaths based on NCI-CTCAE v5.0
Endpoint(s): Summary of pharmacokinetic parameters of BMS-986449 and its metabolite in plasma (e.g. maximum observed concentration within a dosing interval, time of maximum observed concentration and area under the concentration–time curve within a dosing interval from concentration–time data during BMS986449 monotherapy and in combination with nivolumab.

Source: https://euclinicaltrials.eu/ctis-public/view/2023-503484-42-00